EU clinical trial 2024-512849-17-00: A double blind, randomised, placebo-controlled trial evaluating the efficacy and safety of nerandomilast over at least 26 weeks in patients with Systemic Autoimmune Rheumatic Diseases associated Interstitial Lung Diseases (SARD-ILD)
Protocol code: 1305-0046
Sponsor: Boehringer Ingelheim International GmbH, Boehringer Ingelheim Espana S.A. (Pharmaceutical company). Phase: Therapeutic confirmatory (Phase III). Countries: Netherlands (ongoing, recruiting), Germany (ongoing, recruiting), France (ongoing, recruiting), Spain (ongoing, recruiting), Italy (ongoing, recruiting), Austria (ongoing, recruiting), Norway (ongoing, recruiting).
Therapeutic area(s): Diseases [C] - Respiratory Tract Diseases [C08]
Gender: Female, Male. Age: 18-64 years, 65+ years. Enrolment: 158.
Status: Ongoing, recruiting. Start date (EU): 2025-11-14. Decision date: 2025-03-25. Results received: No. Last updated: 2026-07-06.
Decision dates by country: NO: 2025-03-25, AT: 2025-03-31, ES: 2025-03-26, NL: 2025-03-25, IT: 2025-03-27, FR: 2025-03-31, DE: 2025-03-27

Condition(s): Systemic Autoimmune Rheumatic Diseases associated Interstitial Lung Diseases (SARD-ILD)
Product: Placebo matching nerandomilast (BI 1015550), BI 1015550

Primary endpoint: Absolute change from baseline in QILD score [%] on HRCT at Week 26
Endpoint(s): Absolute change from baseline in quantitative lung fibrosis (QLF) score [%] on HRCT at Week 26, Absolute change from baseline in quantitative ground glass opacity (QGGO) score [%] on HRCT at Week 26, Absolute change from baseline in vascular volume [%] on HRCT at Week 26, Absolute change from baseline in FVC [mL] at Week 26, Absolute change from baseline in supplemental oxygen use over the whole trial for oxygen users at Week 26 at baseline, "Time to first supplemental oxygen use during the trial for oxygen non-users at baseline", Occurrence of infection-related AEs from baseline over the duration of the trial

Source: https://euclinicaltrials.eu/ctis-public/view/2024-512849-17-00